EU clinical trial 2022-502187-20-00: Effects of Plasma Exchange with Human Serum Albumin 5% (PE-A 5%) on Short-term Survival in Subjects with Acute-On-Chronic Liver Failure" (ACLF) at High Risk of Hospital Mortality
Protocol code: IG1407
Sponsor: Instituto Grifols S.A. (Pharmaceutical company). Phase: Therapeutic confirmatory (Phase III). Countries: France (ended), Germany (ended), Belgium (ended), Spain (ended), Italy (ended), Austria (ended), Bulgaria (ended), Croatia (ended), Hungary (ended), Romania (ended), Poland (ended).
Therapeutic area(s): Diseases [C] - Digestive System Diseases [C06]
Gender: Female, Male. Age: 18-64 years, 65+ years. Enrolment: 266.
Status: Ended. Start date (EU): 2019-04-11. End date (EU): 2025-04-14. End date: 2025-04-15. Decision date: 2024-02-26. Results received: Yes. Last updated: 2025-01-07.
Decision dates by country: HR: 2024-10-31, HU: 2024-10-21, RO: 2024-09-30, PL: 2024-10-31, DE: 2024-02-27, ES: 2024-02-26, AT: 2024-04-08, FR: 2024-03-19, BE: 2024-03-11, BG: 2024-11-04, IT: 2024-03-06

Condition(s): Subjects with cirrhosis with ACLF-1b, ACLF-2, or ACLF-3a detected either at admission or during hospitalization
Product: Albutein 50 g/l solución para perfusión.

Primary endpoint: The primary efficacy endpoint is to is to compare the 90-day overall survival in the intent-to-treat (ITT) population between the SMT+PE-A 5% treatment group and the SMT control group.
Endpoint(s): The secondary efficacy endpoints are to assess the effects of PE-A 5% on: 1) 90-day transplant-free survival and 2) 28-day overall survival versus SMT alone.

Source: https://euclinicaltrials.eu/ctis-public/view/2022-502187-20-00